EU clinical trial 2024-516736-10-00: Neo-Adjuvant Pembrolizumab as an alternative treatment for MMRd uterine cancer, a phase II efficacy study
Protocol code: PAM-UMCG-002
Sponsor: Universitair Medisch Centrum Groningen (Hospital/Clinic/Other health care facility). Phase: Therapeutic exploratory (Phase II). Countries: Netherlands (ongoing, recruiting).
Therapeutic area(s): Diseases [C] - Female Urogenital Diseases and Pregnancy Complications [C13]; Diseases [C] - Neoplasms [C04]
Gender: Female. Age: 18-64 years, 65+ years. Enrolment: 12.
Status: Ongoing, recruiting. Start date (EU): 2023-12-18. Decision date: 2024-09-05. Results received: No. Last updated: 2026-03-30.

Condition(s): Mismatch repair deficient endometrial cancer / uterine cancer
Product: KEYTRUDA 25 mg/mL concentrate for solution for infusion

Primary endpoint: The main study endpoint is the fraction of patients that achieve a MPR. that the study is considered positive if neo-adjuvant pembrolizumab induces MPRs in at least 74% of patients.
Endpoint(s): The objective response rate of the tumor determined by radiologic assessment using MRI and RECIST1.1., Recurrence-free survival 2 years from disease diagnosis., The safety and tolerability of 9 cycles of neo-adjuvant pembrolizumab in the treatment of MMRd UC.

Source: https://euclinicaltrials.eu/ctis-public/view/2024-516736-10-00